EU clinical trial 2023-503291-24-00: A Phase I/II, First-In-Human, Multi-Part, Open-Label, Multiple-Ascending Dose Study to Investigate the Safety, Tolerability, Pharmacokinetics, Biological, and Clinical Activity of DF1001 in Patients With Locally Advanced or Metastatic Solid Tumors, and Expansion in Selected Indications
Protocol code: DF1001-001
Sponsor: Dragonfly Therapeutics Inc. (Pharmaceutical company). Phase: Phase I and Phase II (Integrated)- Other. Countries: Denmark (ended), Netherlands (ended), Belgium (ended), France (ended).
Therapeutic area(s): Diseases [C] - Neoplasms [C04]
Gender: Female, Male. Age: 18-64 years, 65+ years. Enrolment: 174.
Status: Ended. Start date (EU): 2021-03-17. End date (EU): 2025-12-03. End date: 2025-12-05. Decision date: 2024-11-08. Results received: No. Last updated: 2025-08-25.
Decision dates by country: BE: 2024-11-12, FR: 2024-11-08, DK: 2024-11-10, NL: 2024-12-06

Condition(s): Locally Advanced or Metastatic Solid Tumors, and Expansion in Selected Indications
Product: OPDIVO 10 mg/mL concentrate for solution for infusion., DF1001, Abraxane 5 mg/ml powder for dispersion for infusion., SACITUZUMAB GOVITECAN

Primary endpoint: Dose escalation part: Occurrence of DLTs during the first 21 days of treatment., Dose escalation part: Number, severity, and duration of treatmentemergent adverse events (TEAEs), treatmentrelated adverse events (trAEs), and serious adverse events (SAEs) per Common Terminology Criteria for Adverse Events (CTCAE) v5.0 (cytokine release syndromes will be reported using American Society for Transplantation and Cellular Therapy [ASTCT] criteria)., Dose escalation part: Adverse events of special interest (AESI) and adverse events (AEs) leading to treatment discontinuation., Exploratory Efficacy Part: Number, severity, and duration of drug-related TEAEs for all cohorts and those leading to treatment discontinuation, according to NCI-CTCAE v5, Exploratory Efficacy Part: The ORR, according to RECIST 1.1, per Investigator assessment., Efficacy Expansion Part : The confirmed ORR, according to RECIST 1.1, per Investigator assessment.
Endpoint(s): Dose Escalation Part: PK profile., Dose Escalation Part: OS from initial treatment to death from any cause., Dose Escalation Part: Unconfirmed and confirmed ORR, DOR, unconfirmed and confirmed BOR, and PFS according to RECIST 1.1, per Investigator Assessment., Dose Escalation Part: Immunogenicity parameters., Exploratory Efficacy Part: DOR for confirmed responses according to RECIST 1.1, per Investigator assessment., Exploratory Efficacy Part: DCR according to RECIST 1.1, per Investigator assessment., Exploratory Efficacy Part: PFS according to RECIST 1.1, per Investigator assessment, Exploratory Efficacy Part: OS from initial treatment to death from any cause., Exploratory Efficacy Part: SAEs., Exploratory Efficacy Part: Number, severity, relationship, and duration of TEAEs for all cohorts, according to the NCICTCAE v5.0., Exploratory Efficacy Part: Number, severity, and duration of trAEs according to NCI-CTCAE v5.0., Exploratory Efficacy Part: Physical examination., Exploratory Efficacy Part: Vital sign measurements., Exploratory Efficacy Part: clinical laboratory parameters, Exploratory Efficacy Part: ECG parameters, Echocardiogram (ECHO) or multigated acquisition (MUGA) scan findings., Exploratory Efficacy Part: Anti-drug antibody., Exploratory Efficacy Part: PK profile., Efficacy Expansion Part: DOR, confirmed BOR, and PFS per Investigator assessment.

Source: https://euclinicaltrials.eu/ctis-public/view/2023-503291-24-00